EU clinical trial 2023-505847-38-00: SAD and MAD study of VES001
Protocol code: CHDR2309
Sponsor: Insusense ApS (Pharmaceutical company). Phase: Human Pharmacology (Phase I)- First administration to humans. Countries: Netherlands (ended).
Therapeutic area(s): Analytical, Diagnostic and Therapeutic Techniques and Equipment [E] - Investigative Techniques [E05]
Gender: Female, Male. Age: 18-64 years. Enrolment: 78.
Status: Ended. Start date (EU): 2023-10-11. End date (EU): 2024-07-26. Decision date: 2023-10-11. Results received: No. Last updated: 2024-04-15.

Condition(s): Frontotemporal dementia (FTD)

Source: https://euclinicaltrials.eu/ctis-public/view/2023-505847-38-00